EU clinical trial 2023-505017-25-02: Treatment of difficult-to-heal wounds with stem cells included in a gel consistency dressing
Protocol code: THC0721
Sponsor: Fundacion Para La Investigacion Y La Innovacion Biosanitaria Del Principado De Asturias (Laboratory/Research/Testing facility). Phase: Phase I and Phase II (Integrated)- First administration to humans. Countries: Spain (ongoing, recruiting).
Therapeutic area(s): Diseases [C] - Skin and Connective Tissue Diseases [C17]
Gender: Female, Male. Age: 18-64 years, 65+ years. Enrolment: 10.
Status: Ongoing, recruiting. Start date (EU): 2024-06-10. Decision date: 2024-03-22. Results received: No. Last updated: 2026-06-01.

Condition(s): Hard-to-heal-wounds

Source: https://euclinicaltrials.eu/ctis-public/view/2023-505017-25-02